EU clinical trial 2024-512379-10-00: A Phase II, Non-comparative, Open label, Multi-centre, International Study of MEDI4736, in Patients with Locally Advanced or Metastatic Non‑Small Cell Lung Cancer (Stage IIIB-IV) who have received at least Two Prior Systemic Treatment Regimens Including One Platinum-based Chemotherapy Regimen (ATLANTIC)
Protocol code: D4191C00003
Sponsor: AstraZeneca AB (Pharmaceutical company). Phase: Therapeutic exploratory (Phase II). Countries: Belgium (ended).
Therapeutic area(s): Diseases [C] - Neoplasms [C04]
Gender: Female, Male. Age: 18-64 years, 65+ years. Enrolment: 1.
Status: Ended. Start date (EU): 2014-09-23. End date (EU): 2025-03-26. End date: 2025-03-26. Decision date: 2024-05-22. Results received: Yes. Last updated: 2025-03-28.

Condition(s): Locally Advanced or Metastatic Non-Small Cell Lung Cancer (Stage IIIBIV)
Product: IMFINZI 50 mg/mL concentrate for solution for infusion.

Primary endpoint: Objective response rate (ORR) (per RECIST 1.1) Timepoint(s) of evaluation of this end point For each cohort, the data cut-off for the analysis of ORR will take place approximately 24 weeks after the last patient is enrolled into each cohort.
Endpoint(s): - Duration of response - Progression free survival - Disease control rate - Overall survival - Deep sustained response - AEs Timepoint(s) of evaluation of this end point The data cut-off for analysis of the secondary efficacy endpoints will take place approximately 8 months after recruitment ends. The final analysis of OS (secondary endpoint) will take place approximately 12 months after the last patient is enrolled into each cohort.

Source: https://euclinicaltrials.eu/ctis-public/view/2024-512379-10-00